EU clinical trial 2023-508420-36-00: Phase I clinical trial on the use of fresh, allogeneic, second-generation CD19-CAR T cells for treatment of children and young adult with relapsed/refractory B-cell Acute Lymphoblastic Leukemia
Protocol code: AlloCAR
Sponsor: Ospedale Pediatrico Bambino Gesu' (Hospital/Clinic/Other health care facility). Phase: Human Pharmacology (Phase I)- First administration to humans. Countries: Italy (ongoing, recruiting).
Therapeutic area(s): Diseases [C] - Hemic and Lymphatic Diseases [C15]
Gender: Female, Male. Age: 0-17 years, 18-64 years. Enrolment: 24.
Status: Ongoing, recruiting. Start date (EU): 2024-04-23. Decision date: 2024-04-17. Results received: No. Last updated: 2026-05-22.
Decision dates by country: IT: 2024-04-23

Condition(s): Relapsed/refractory B-cell Acute Lymphoblastic Leukemia
Product: Fludara 50 mg powder for solution for injection or infusion., Cyclophosphamide Injection 1 g.

Primary endpoint: To evaluate the safety of the infusion of CD19-CAR_Lenti_ALLO evaluating 2 dose levels (DLs) for each cohort of patients, depending on the donor HLA-matching (for fully matched, familial or unrelated donor, DL1: 3.0 x 106; DL2: 5.0 x 106 cells/kg recipient total body weight of CAR+ T cells; for haploidentical donor, DL1: 1.0 x 106; DL2: 3.0 x 106 cells/kg recipient total body weight of CAR+ T cells) and establish the dose-limiting toxicity (DLT) of the cellular product. DLT will be defined as an
Endpoint(s): 1. To estimate the rate of occurrence and the severity of acute and/or chronic GvHD 2. To evaluate the proportion of patients achieving either CR or CR with incomplete blood count recovery (CRi) and MRD negativity by either flow-cytometry or qPCR at day 28 (defined as a value < 1x10-4 ). 3. To estimate the probability of obtaining CR with MRD negativity stratified according to the disease burden at time of enrollment

Source: https://euclinicaltrials.eu/ctis-public/view/2023-508420-36-00